EU clinical trial 2022-502250-14-00: Treatment of rhinosinusitis with nasal polyposis with dupilumab and mepolizumab: A randomized, multi-centre, head-to-head comparison in real-world Danish patients
Protocol code: TORNADO
Sponsor: Rigshospitalet (Hospital/Clinic/Other health care facility). Phase: Therapeutic use (Phase IV). Countries: Denmark (ongoing, recruitment ended).
Therapeutic area(s): Diseases [C] - Otorhinolaryngologic Diseases [C09]; Diseases [C] - Respiratory Tract Diseases [C08]
Gender: Female, Male. Age: 18-64 years, 65+ years. Enrolment: 220.
Status: Ongoing, recruitment ended. Start date (EU): 2023-04-13. Decision date: 2023-03-22. Results received: No. Last updated: 2025-10-29.

Condition(s): Chronic rhinosinusitis with nasal polyposis
Product: Dupixent 300 mg solution for injection in pre-filled syringe, Nucala 100 mg powder for solution for injection, Prednisolon Alternova 5 mg tabletter, Nasonex, næsespray, suspension

Primary endpoint: Co-primary endpoint 1: Change in nasal polyp score (NPS) at 24 weeks, Co-primary endpoint 2: Change in SNOT-22 score at 24 weeks
Endpoint(s): Change in loss of smell (Proportion with SSIT-16 improved to >8), Improvement in asthma (measured by proportion with ACQ>0.5), Improvement on visual analog scale measuring impact on quality of life of CRSwNP, Tympanometry - proportion with change from B-curve to A or C curve., Expired Nitrous oxide (FeNO) - proportion with less than 25 ppb, Improvement in subjective smell function by visual analog scale, Improvement in aspirin-exacerbated-respiratory-intolerance (AERD) measured by visual analog scale., Improvement in NPS at 52 weeks, Improvement in SNOT-22 at 52 weeks, Proportion meeting the response criteria set by the Danish Medicines council, Proportion of subjects needing rescue treatment (systemic corticosteroids or sinus surgery), Change in Nasal Congestion Score (NCS), Chang in radiologic sinus opacification (Lund-Mackey score), Change in FEV1

Source: https://euclinicaltrials.eu/ctis-public/view/2022-502250-14-00